EU clinical trial 2025-522964-33-00: A Phase 4, Multicenter, Double-blind, Study to Investigate the Efficacy, Safety, and Tolerability of 3 Active Doses of Respreeza® / Zemaira® Weekly Intravenous Infusions Administered over 3 Years as Longterm Maintenance Therapy in Adult Subjects with Emphysema Related to Alpha1 Antitrypsin Deficiency
Protocol code: CE1226_4003
Sponsor: CSL Behring LLC (Pharmaceutical company). Phase: Therapeutic use (Phase IV). Countries: Denmark (authorised, recruitment pending).
Therapeutic area(s): Diseases [C] - Respiratory Tract Diseases [C08]
Gender: Female, Male. Age: 18-64 years, 65+ years. Enrolment: 33.
Status: Authorised, recruitment pending. Decision date: 2026-05-28. Results received: No. Last updated: 2026-05-28.

Condition(s): Alpha1-proteinase inhibitor deficiency, Alpha1 antitrypsin deficiency, Emphysema
Product: Respreeza 4,000 mg powder and solvent for solution for infusion., Respreeza 1,000 mg powder and solvent for solution for infusion.

Primary endpoint: Annual rate of change in adjusted lung density
Endpoint(s): 1. Annual rate of change in forced expiratory volume in 1 second percent predicted (FEV1%) 2. Annual rate of change in diffusion capacity of carbon monoxide (DLco) 3. Number of severe pulmonary exacerbations 4. Duration of severe pulmonary exacerbations 5. Number of participants experiencing treatment emergent adverse events (TEAEs) 6. Percentage of participants experiencing TEAEs

Source: https://euclinicaltrials.eu/ctis-public/view/2025-522964-33-00